EU clinical trial 2026-526135-18-00: A randomised, open-label, single-centre, drug-drug-interaction trial to evaluate the impact of carboxylesterase 2 (CES2)- and CYP3A4-inhibition on the pharmacokinetics of buloxibutid in healthy volunteers
Protocol code: VP-C21-016
Sponsor: Vicore Pharma AB (Pharmaceutical company). Phase: Human Pharmacology (Phase I)- Other. Countries: Sweden (ongoing, recruiting).
Therapeutic area(s): Diseases [C] - Respiratory Tract Diseases [C08]
Gender: Female, Male. Age: 18-64 years. Enrolment: 24.
Status: Ongoing, recruiting. Start date (EU): 2026-05-12. Decision date: 2026-04-28. Results received: No. Last updated: 2026-06-11.

Condition(s): Idiopathic pulmonary fibrosis

Source: https://euclinicaltrials.eu/ctis-public/view/2026-526135-18-00